EU clinical trial 2024-512064-61-00: Daily versus alternate day oral iron supplementation for the treatment of iron deficiency anaemia in pregnancy (IronMother)
Sponsor: University College Dublin (Educational Institution). Phase: Therapeutic use (Phase IV). Countries: Ireland (ended).
Therapeutic area(s): Diseases [C] - Female Urogenital Diseases and Pregnancy Complications [C13]
Gender: Female. Age: 18-64 years. Enrolment: 230.
Status: Ended. Start date (EU): 2023-04-21. End date (EU): 2025-05-01. Decision date: 2024-05-17. Results received: No. Last updated: 2025-03-03.

Condition(s): Iron deficiency anaemia in pregnancy
Product: Galfer 305mg Hard Capsules

Primary endpoint: Hb levels at 4 weeks post IMP treatment
Endpoint(s): Compliance as measured by objective pill count at 4 week assessment, Serum ferritin levels in both groups after 4 weeks treatment, Compliance as measured by questionnaire at 4 week assessment, Tolerance as measured by gastrointestinal symptom questionnaire at 4 week assessment, Obstetric and neonatal outcomes : o Delivery outcomes (livebirth, stillbirth, NND) o Mode of delivery (OVD, SVD, LSCS) o Rates and quantitation of primary PPH o Postnatal blood transfusion in the two weeks post-delivery (Y/N, if yes for RCC no. of units) o Postnatal iron transfusion in the two weeks post-delivery o Neonatal Intensive Care Unit admission (Y/N) o Apgar scores (at 1 and 5 minutes of life as standard) o Birth weights o Most recent Hb levels at term (37-42 wks gestation)

Source: https://euclinicaltrials.eu/ctis-public/view/2024-512064-61-00